EU clinical trial 2024-518559-41-01: Amyloid pathology in cognitively normal elderly subjects (PreclinAD)
Sponsor: Amsterdam UMC Stichting (Patient organisation/association). Phase: Therapeutic exploratory (Phase II). Countries: Netherlands (ongoing, recruiting).
Therapeutic area(s): Diseases [C] - Nervous System Diseases [C10]
Gender: Female, Male. Age: 65+ years. Enrolment: 204.
Status: Ongoing, recruiting. Start date (EU): 2024-11-29. Decision date: 2024-11-29. Results received: No. Last updated: 2024-11-29.

Condition(s): Healthy controls (investigating preclinical Alzheimer's Disease)
Product: VIZAMYL 400 MBq/mL solution for injection

Primary endpoint: 1.To identify clinical markers and biomarkers for amyloid pathology in cognitively normal subjects; 2.To identify risk factors for (change in) amyloid pathology in cognitively normal subjects, 3.To identify prognostic markers for cognitive decline in cognitively normal subjects with amyloid pathology

Source: https://euclinicaltrials.eu/ctis-public/view/2024-518559-41-01